EU clinical trial 2023-503916-33-00: A Phase 3 Randomized Study of Loncastuximab Tesirine Combined with Rituximab Versus Immunochemotherapy in Patients with Relapsed or Refractory Diffuse Large B-Cell Lymphoma (DLBCL) (LOTIS-5)
Protocol code: ADCT-402-311
Sponsor: ADC Therapeutics S.A. (Pharmaceutical company). Phase: Therapeutic confirmatory (Phase III). Countries: Hungary (ongoing, recruitment ended), Italy (ongoing, recruitment ended), Belgium (ongoing, recruitment ended), France (ongoing, recruitment ended), Netherlands (ended), Poland (ongoing, recruitment ended), Czechia (ongoing, recruitment ended), Spain (ongoing, recruitment ended).
Therapeutic area(s): Diseases [C] - Neoplasms [C04]
Gender: Female, Male. Age: 18-64 years, 65+ years. Enrolment: 228.
Start date (EU): 2021-03-24. Decision date: 2024-03-07. Results received: No. Last updated: 2026-03-20.
Decision dates by country: NL: 2024-04-08, PL: 2024-03-15, BE: 2024-03-21, FR: 2024-04-09, HU: 2024-03-07, ES: 2024-06-07, CZ: 2024-03-12, IT: 2024-03-25

Condition(s): Diffuse Large B-Cell Lymphoma (DLBCL)
Product: GEMCITABINE, Truxima 100 mg concentrate for solution for infusion, Truxima 100 mg concentrate for solution for infusion, Zynlonta 10 mg powder for concentrate for solution for infusion, Dexamethason 4 mg GALEN®, Truxima 100 mg concentrate for solution for infusion, OXALIPLATIN, Truxima 100 mg concentrate for solution for infusion

Primary endpoint: Progression-free survival (PFS) defined as the time between randomization and the first documentation of recurrence or progression by independent central review, or death from any cause

Source: https://euclinicaltrials.eu/ctis-public/view/2023-503916-33-00